EU clinical trial 2025-524371-23-00: An Open-Label Extension Study to Evaluate the Long-Term Safety and Efficacy of BBP-418 (Ribitol) in Participants with Limb-Girdle Muscular Dystrophy 2I/R9 (LGMD2I/R9)
Protocol code: MLB-01-007
Sponsor: ML Bio Solutions Inc. (Pharmaceutical company). Phase: Therapeutic confirmatory (Phase III). Countries: Germany (authorised, recruitment pending), Denmark (authorised, recruitment pending), Netherlands (authorised, recruitment pending), Italy (authorised, recruitment pending), Norway (authorised, recruitment pending).
Therapeutic area(s): Diseases [C] - Musculoskeletal Diseases [C05]
Gender: Female, Male. Age: 18-64 years. Enrolment: 35.
Status: Authorised, recruitment pending. Decision date: 2026-06-15. Results received: No. Last updated: 2026-07-10.
Decision dates by country: DK: 2026-06-16, IT: 2026-06-22, NL: 2026-06-15, NO: 2026-06-17, DE: 2026-07-10

Condition(s): Limb Girdle Muscular Dystrophy (LGMD) Type 2I
Product: Ribitol

Primary endpoint: -Frequency and severity of TEAEs and treatment-emergent SAEs - Change from baseline in NSAD at EOT
Endpoint(s): • Change from baseline in the following endpoints at EOT: o 10MWT (m/s) o FVC (percent predicted, performed in a sitting position) o PUL 2.0 (for participants who are non-ambulatory at OLE baseline) o 100MTT • Change from baseline in serum CK at EOT

Source: https://euclinicaltrials.eu/ctis-public/view/2025-524371-23-00